EU clinical trial 2024-514530-21-00: Assessment of clozapine-related immunodeficiency effect in Parkinson's disease patients (CLOZIDPD)
Sponsor: Centre Hospitalier Universitaire Amiens Picardie (Hospital/Clinic/Other health care facility). Phase: Therapeutic use (Phase IV). Countries: France (authorised, recruitment pending).
Therapeutic area(s): Diseases [C] - Nervous System Diseases [C10]
Gender: Female, Male. Age: 18-64 years, 65+ years. Enrolment: 24.
Status: Authorised, recruitment pending. Decision date: 2024-08-23. Results received: No. Last updated: 2024-08-23.

Condition(s): Parkinson's disease
Product: CLOZAPINE

Primary endpoint: change in serum IgG levels before initiation of treatment with clozapine and then 6 months after initiation of treatment.
Endpoint(s): The variation in the patient's weight (weighed during visits D0, M6 and M12), The number of infections presented by the patient (oral collection during visits to M6 and M12), The use of antibiotics by the patient (oral collection during visits to M6 and M12), Tolerance / adverse effects of treatment with Clozapine (collected during visits to M6 and M12), Variation in motor status, quality of life, depressive syndrome, apathy, global cognitive efficiency and psychotic elements assessed on the clinical scales MDS-UPDRS, PDQ39, Goldberg, Starkstein, MoCA and the neuropsychological inventory (NPI) (carried out during visits D0, M6 and M12)., - Variation in serum IgA level (on blood test taken on D0, M6 and M12), Variation in serum IgM level (on blood test taken on D0, M6 and M12), Variation in IgG levels with the IgG1, IgG2, IgG3 and IgG4 subclasses (on blood samples taken on D0, M6 and M12), Variation in CBC parameters (on blood test taken on D0, M6 and M12), Variation in CRP level (on blood test taken on D0, M6 and M12), Change in serum Clozapine level (on blood test taken at M6 and M12), Variation in T, B and NK lymphocyte subpopulations (on blood samples taken on D0, M6 and M12)

Source: https://euclinicaltrials.eu/ctis-public/view/2024-514530-21-00